EU clinical trial 2023-509486-20-00: Evaluating T Cell Changes and Activation in Cancer Patient Using Two PET Tracers (iRelate)
Protocol code: 2023-509486-20-00
Sponsor: Amsterdam UMC (Hospital/Clinic/Other health care facility). Phase: Phase II and Phase III (Integrated). Countries: Netherlands (ended).
Therapeutic area(s): Diseases [C] - Neoplasms [C04]
Gender: Female, Male. Age: 18-64 years, 65+ years. Enrolment: 34.
Status: Ended. Start date (EU): 2024-05-29. End date (EU): 2026-01-16. Decision date: 2024-05-22. Results received: No. Last updated: 2025-01-30.

Condition(s): Breast cancer, Esophageal Cancer, Melanoma, Non-Small Cell Lung Carcinoma
Product: Zr89, NELARABINE

Primary endpoint: Main trial endpoints and their analysis: • The spatial overlap of the regions of uptake for both PET tracers will be assessed using the Dice Similarity Coefficient (DSC) as an established method. • The Pearson correlation coefficient between each tracer tumor uptake and the T cell features in regions of concordance and discordance.
Endpoint(s): Secondary trial endpoints and their analysis: • The Pearson correlation coefficient between each tracer tumor uptake and percentage of residual viable tumor cells (VTC) in regions of concordance and discordance and the maximal VTC of the whole of the tumor. • The Pearson correlation coefficient between each tracer uptake and the T cell features in resected lymph nodes (if present).

Source: https://euclinicaltrials.eu/ctis-public/view/2023-509486-20-00